EU clinical trial 2023-510118-21-00: Strategies towards personalised treatment in Juvenile Idiopathic Arthritis (JIA): An open randomised multicentre blinded-assessor trial assessing the effectiveness of intraarticular glucocorticoid injections in JIA patients starting tumour necrosis factor inhibitor treatment. The MyJIA trial.
Sponsor: Oslo University Hospital HF (Hospital/Clinic/Other health care facility). Phase: Therapeutic use (Phase IV). Countries: Norway (ended).
Therapeutic area(s): Diseases [C] - Musculoskeletal Diseases [C05]
Gender: Female, Male. Age: 0-17 years. Enrolment: 188.
Status: Ended. Start date (EU): 2020-12-01. End date (EU): 2025-02-06. Decision date: 2024-05-15. Results received: No. Last updated: 2024-05-15.

Condition(s): Juvenile Idiopathic Arthritis
Product: Lederspan, injektionsvæske, suspension

Primary endpoint: The proportion of participants with sustained, inactive disease (according to the Wallace 2011 criteria) and no i.a. or p.o. glucocorticoid use from week 24 to 36.
Endpoint(s): 30% improvement in the paediatric American College of Rheumatology criteria (ACR Pedi 30 improvement) at week 24.

Source: https://euclinicaltrials.eu/ctis-public/view/2023-510118-21-00